EU clinical trial 2023-506831-13-00: Efficacy and Safety of Concizumab prophylaxis in patients with haemophilia A or B without inhibitors
Protocol code: NN7415-4307
Sponsor: Novo Nordisk A/S (Pharmaceutical company). Phase: Therapeutic confirmatory (Phase III). Countries: Estonia (ongoing, recruitment ended), Portugal (ongoing, recruitment ended), Spain (ongoing, recruitment ended), Italy (ongoing, recruitment ended), Germany (ended), Denmark (ended), France (ended), Hungary (ongoing, recruitment ended), Poland (ongoing, recruitment ended), Sweden (ongoing, recruitment ended), Lithuania (ongoing, recruitment ended).
Therapeutic area(s): Diseases [C] - Congenital, Hereditary, and Neonatal Diseases and Abnormalities [C16]
Gender: Male. Age: 0-17 years, 18-64 years, 65+ years. Enrolment: 41.
Start date (EU): 2020-01-15. Decision date: 2024-02-07. Results received: No. Last updated: 2026-08-04.
Decision dates by country: DK: 2024-02-07, PT: 2024-02-07, LT: 2024-03-18, HU: 2024-02-08, DE: 2024-02-09, FR: 2024-02-12, IT: 2024-02-08, SE: 2024-02-08, ES: 2024-02-08, PL: 2024-02-13, EE: 2024-02-12

Condition(s): haemophilia A (HA) without inhibitors and haemophilia B (HB) without inhibitors
Product: Concizumab C 100 mg/mL PDS290, Concizumab C 40 mg/mL PDS290

Primary endpoint: For haemophilia A patients without inhibitors: the number of treated spontaneous and traumatic bleeding episodes On demand (arm 1) From randomisation after the pause (week 0) up until start of concizumab treatment (week 24) Concizumab (arm 2) From start of the new concizumab dosing regimen (week 0) up until the confirmatory analyses cut-off (at least 32 weeks), For haemophilia B patients without inhibitors: the number of treated spontaneous and traumatic bleeding episodes On demand (arm 1) From randomisation after the pause (week 0) up until start of concizumab treatment (week 24) Concizumab (arm 2) From start of the new concizumab dosing regimen (week 0) up until the confirmatory analyses cut-off (at least 32 weeks)
Endpoint(s): For haemophilia A patients without inhibitors: The number of treated spontaneous and traumatic bleeding episodes Arm 4 patients who have been on stable PPX at least 24 weeks in study 4322 For previous PPX (study 4322): From the point in time where PPX is stable and up until the end of study. For concizumab PPX (trial 4307): From the point in time where the concizumab maintenance dose is confirmed, increased or decreased and up until the confirmatory analyses cut-off (at least 24 weeks)., For haemophilia B patients without inhibitors: The number of treated spontaneous and traumatic bleeding episodes Arm 4 patients who have been on stable PPX at least 24 weeks in study 4322 For previous PPX (study 4322): From the point in time where PPX is stable and up until the end of study. For concizumab PPX (trial 4307): From the point in time where the concizumab maintenance dose is confirmed, increased or decreased and up until the confirmatory analyses cut-off (at least 24 weeks)., For haemophilia A patients without inhibitors: Number of treated spontaneous bleeding episodes On demand (arm 1) From randomisation after the pause (week 0) up until start of concizumab treatment (week 24) Concizumab (arm 2) From start of the new concizumab dosing regimen (week 0) up until the confirmatory analyses cut-off (at least 32 weeks), For haemophilia B patients without inhibitors: Number of treated spontaneous bleeding episodes On demand (arm 1) From randomisation after the pause (week 0) up until start of concizumab treatment (week 24) Concizumab (arm 2) From start of the new concizumab dosing regimen (week 0) up until the confirmatory analyses cut-off (at least 32 weeks), For haemophilia A patients without inhibitors: Number of treated spontaneous and traumatic joint bleeds On demand (arm 1) From randomisation after the pause (week 0) up until start of concizumab treatment (week 24) Concizumab (arm 2) From start of the new concizumab dosing regimen (week 0) up until the confirmatory analyses cut-off (at least 32 weeks), For haemophilia B patients without inhibitors: Number of treated spontaneous and traumatic joint bleeds On demand (arm 1) From randomisation after the pause (week 0) up until start of concizumab treatment (week 24) Concizumab (arm 2) From start of the new concizumab dosing regimen (week 0) up until the confirmatory analyses cut-off (at least 32 weeks), For haemophilia A patients without inhibitors: Number of treated spontaneous and traumatic target joint bleeds On demand (arm 1) From randomisation after the pause (week 0) up until start of concizumab treatment (week 24) Concizumab (arm 2) From start of the new concizumab dosing regimen (week 0) up until the confirmatory analyses cut-off (at least 32 weeks), For haemophilia B patients without inhibitors: Number of treated spontaneous and traumatic target joint bleeds On demand (arm 1) From randomisation after the pause (week 0) up until start of concizumab treatment (week 24) Concizumab (arm 2) From start of the new concizumab dosing regimen (week 0) up until the confirmatory analyses cut-off (at least 32 weeks), Number of thromboembolic events On demand (arm 1 main part) From randomisation to on demand treatment until start of concizumab treatment Concizumab (arms 2-4) Before the pause: From start of concizumab treatment up until 7 weeks after the treatment was paused and After the pause: From start of concizumab treatment up until the confirmatory analyses cut-off (at least 32 weeks) Concizumab (arm 1 extension part) From start of concizumab treatment up until the confirmatory analysis cut-off, Number of thromboembolic events Concizumab Before the pause: From start of treatment (week 0) up until 7 weeks after the treatment was paused as well as After the pause: From start of concizumab treatment up until the end of trial (up to 384 weeks), Number of hypersensitivity type reactions On demand (arm 1 main part) From randomisation to on demand treatment up until start of concizumab treatment Concizumab (arms 2-4) Before the pause: From start of concizumab treatment up until 7 weeks after the treatment was paused and After the pause: From start of concizumab treatment up until the confirmatory analyses cut-off (at least 32 weeks) Concizumab (arm 1 extension) From start of concizumab treatment up until the confirmatory analysis cut-off, Number of hypersensitivity type reactions Concizumab Before the pause: From start of treatment (week 0) up until 7 weeks after the treatment was paused as well as After the pause: From start of concizumab treatment up until the end of trial (up to 384 weeks), Number of injection site reactions On demand (arm 1 main part) From randomisation to on demand treatment until start of concizumab treatment Concizumab (arms 2-4) Before the pause: From start of concizumab treatment up until 7 weeks after the treatment was paused and After the pause: From start of concizumab treatment up until the confirmatory analyses cut-off (at least 32 weeks) Concizumab (arm 1 extension part) From start of concizumab treatment up until the confirmatory analysis cut-off, Number of injection site reactions Concizumab Before the pause: From start of treatment (week 0) up until 7 weeks after the treatment was paused as well as After the pause: From start of concizumab treatment up until the end of trial (up to 384 weeks), Number of patients with antibodies to concizumab Concizumab (arms 2-4) Before the pause: From start of concizumab treatment (week 0) up until 7 weeks after the treatment was paused as well as After the pause: From start of concizumab treatment (week 0) up until the confirmatory analyses cut-off (at least 32 weeks) Concizumab (arm 1 extension part) From start of concizumab treatment (visit 9a) up until the confirmatory analysis cut-off, Number of patients with antibodies to concizumab Concizumab Before the pause: From start of treatment (week 0) up until 7 weeks after the treatment was paused as well as After the pause: From start of concizumab treatment up until the end of trial (up to 384 weeks), Pre-dose (trough) concizumab plasma concentration (Ctrough) prior to the concizumab administration at week 24 (after restart), Pre-dose thrombin peak prior to the concizumab administration at week 24 (after restart), Pre-dose free TFPI concentration prior to the concizumab administration at week 24 (after restart), Maximum concizumab plasma concentration (Cmax) from 0 to 24 hours where 0 is time of the concizumab dose at week 24 (after restart), Area under the concizumab plasma concentration-time curve (AUC) from 0 to 24 hours where 0 is time of the concizumab dose at week 24 (after restart)

Source: https://euclinicaltrials.eu/ctis-public/view/2023-506831-13-00